EU clinical trial 2024-518059-50-00: Intraoperative methadone for the prevention of postoperative pain: a randomized, double-blind clinical study in orthopedic surgery
Protocol code: CHUB-Methadone
Sponsor: Association Hospitaliere De Bruxelles Et De Schaerbeek Centre Hospitalier Universitaire Brugmann (Hospital/Clinic/Other health care facility). Phase: Therapeutic confirmatory (Phase III). Countries: Belgium (ongoing, recruiting).
Therapeutic area(s): Analytical,Diagnostic,Therapeutic Techniques and Equipment [E]-Surgical Procedures, Operative [E04]
Gender: Female, Male. Age: 18-64 years, 65+ years. Enrolment: 80.
Status: Ongoing, recruiting. Start date (EU): 2023-03-01. Decision date: 2024-12-12. Results received: No. Last updated: 2025-11-26.

Condition(s): Orthopedic surgery
Product: MEPHENON 10mg/1ml solution injectable, Sufenta

Primary endpoint: Postoperative pain will be assessed by nurses in the recovery room and inpatient unit: total morphine consumption is noted and postoperative pain is assessed using a standard visual analogue scale (VAS) in 11 points (from 0 to 10) at rest and during coughing at 11 different intervals. The level of sedation is also measured using a 5-point scale (Rudkin scale) and episodes of nausea and vomiting, side effects and complications are also encoded.
Endpoint(s): The pain is then evaluated during the three postoperative days thanks to the EVA but also via a general satisfaction questionnaire concerning the management of pain at the end of the stay. Side effects and complications are encoded.

Source: https://euclinicaltrials.eu/ctis-public/view/2024-518059-50-00